EU clinical trial 2023-509450-55-01: Prevention of CKD progression in type 1 diabetes with Long term Use of SGLTi avoiding kidney hypOxia (PLUTO)
Sponsor: Steno Diabetes Center Copenhagen (Hospital/Clinic/Other health care facility). Phase: Therapeutic exploratory (Phase II). Countries: Denmark (ongoing, recruiting).
Therapeutic area(s): Diseases [C] - Hormonal diseases [C19]; Diseases [C] - Nutritional and Metabolic Diseases [C18]; Phenomena and Processes [G] - Metabolism [G03]
Gender: Female, Male. Age: 18-64 years, 65+ years. Enrolment: 39.
Status: Ongoing, recruiting. Start date (EU): 2025-04-01. Decision date: 2024-08-08. Results received: No. Last updated: 2025-10-17.

Condition(s): Type 1 Diabetes Mellitus with chronic kidney complications
Product: SOTAGLIFLOZIN, PLACEBO PRODUCT [PLACEBO MATCHING SOTAGLIFLOZIN 200 MG FILM-COATED TABLETS]

Primary endpoint: Change from 0 to 12 weeks in dynamic R2*-weighted signal (BOLD) as an indirect measure of renal blood oxygenation after treatment with sotagliflozin compared with placebo.

Source: https://euclinicaltrials.eu/ctis-public/view/2023-509450-55-01